EU clinical trial 2023-504179-26-00: COmparison of Bleeding Risk between Rivaroxaban and Apixaban for the treatment of acute venous thromboembolism
Sponsor: Royal College Of Surgeons In Ireland (Educational Institution). Phase: Therapeutic use (Phase IV). Countries: Ireland (ended).
Therapeutic area(s): Diseases [C] - Cardiovascular Diseases [C14]
Gender: Female, Male. Age: 18-64 years, 65+ years. Enrolment: 24.
Status: Ended. Start date (EU): 2024-07-19. End date (EU): 2025-04-10. Decision date: 2023-06-23. Results received: Yes. Last updated: 2024-07-15.

Condition(s): Acute Venous Thromboembolism
Product: Xarelto 15 mg film-coated tablets, Eliquis 5 mg film-coated tablets, Xarelto 20 mg film-coated tablets

Primary endpoint: The primary outcome is the rate of adjudicated clinically relevant bleeding (CRB) events defined as the composite of major bleeding (MB) events and/or clinically relevant non-major bleeding events (CRNMB).
Endpoint(s): a) adjudicated MB events; b) adjudicated CRNMB events; c) adjudicated recurrent VTE events; d) adjudicated VTE-related deaths; e) all-cause mortality; f) medication adherence; g) incremental cost-effectiveness ratios, including cost per one CRB case prevented, cost per one life year saved and cost per one quality-adjusted life year (QALY) gained; h) impact of verbal consent on patient participation in comparison with participants from sites using written informed consent.

Source: https://euclinicaltrials.eu/ctis-public/view/2023-504179-26-00